EU clinical trial 2023-508157-15-01: IAVI C110 HIV Vaccine Trial
Protocol code: IAVI C110
Sponsor: International AIDS Vaccine Initiative Inc. (Laboratory/Research/Testing facility). Phase: Human Pharmacology (Phase I)- First administration to humans. Countries: Netherlands (ongoing, recruitment ended).
Therapeutic area(s): Diseases [C] - Virus Diseases [C02]
Gender: Female, Male. Age: 18-64 years. Enrolment: 6.
Status: Ongoing, recruitment ended. Start date (EU): 2024-03-19. Decision date: 2024-02-09. Results received: No. Last updated: 2024-02-09.

Condition(s): Human Immunodeficiency Virus (HIV)

Source: https://euclinicaltrials.eu/ctis-public/view/2023-508157-15-01